EU clinical trial 2024-515193-27-00: A 24-week, multicenter, randomized, double blind, placebo-controlled, dose-range finding phase II study to compare efficacy and safety of oral masitinib to placebo in treatment of patients with severe mast cell activation syndrome (MCAS) with handicap unresponsive to optimal symptomatic treatment
Protocol code: AB20006
Sponsor: Ab Science (Pharmaceutical company). Phase: Therapeutic exploratory (Phase II). Countries: France (ended).
Therapeutic area(s): Diseases [C] - Hemic and Lymphatic Diseases [C15]
Gender: Female, Male. Age: 18-64 years, 65+ years. Enrolment: 5.
Status: Ended. Start date (EU): 2024-09-19. End date (EU): 2026-07-03. Decision date: 2024-09-19. Results received: No. Last updated: 2025-12-01.

Condition(s): Mast cell activation syndrome
Product: masitinib, masitinib, Placebo to 100mg masitinib, Placebo to 200mg masitinib

Primary endpoint: The primary endpoint is confirmed response at 50% at week 24 using stratified Cochran Mantel-Haenszel (CMH) test on 4 handicap scores (pruritus, flush, depression, fatigue).
Endpoint(s): • Cumulative and every four weeks (every patient’s visit) response at 75% on 4 handicaps (pruritus, flush, depression, fatigue) from week 8 to week 24., • Confirmed response (CR) at 75% at week 24, Two evaluations will be done for each of the following end points as an improvement of response >50% and ≥75%: • Cumulative and every four weeks (every patient’s visit) response on 4 handicaps (pruritus, flushes, depression, fatigue by FSS) from week 8 to week 24. • Cumulative and every four weeks (every patient’s visit) response on 4 handicaps (pruritus, flush, depression, fatigue by FIS) from week 8 to week 24. •Cumulative and every four weeks (every patient’s visit) response on 2 handicaps (

Source: https://euclinicaltrials.eu/ctis-public/view/2024-515193-27-00